EU clinical trial 2024-512654-19-00: A Long-term Follow-up Study of Subjects with β-Thalassemia or Sickle Cell Disease Treated with Autologous CRISPR-Cas9 Modified Hematopoietic Stem Cells (CTX001)
Protocol code: VX18-CTX001-131
Sponsor: Vertex Pharmaceuticals Inc. (Pharmaceutical company). Phase: Therapeutic confirmatory (Phase III). Countries: Belgium (ongoing, recruiting), Italy (ongoing, recruiting), Germany (ongoing, recruiting).
Therapeutic area(s): Diseases [C] - Congenital, Hereditary, and Neonatal Diseases and Abnormalities [C16]
Gender: Female, Male. Age: 0-17 years, 18-64 years. Enrolment: 37.
Status: Ongoing, recruiting. Start date (EU): 2020-03-06. Decision date: 2024-06-05. Results received: No. Last updated: 2026-03-02.
Decision dates by country: IT: 2024-06-24, BE: 2024-06-05, DE: 2024-06-19

Condition(s): Sickle Cell Disease, Transfusion dependent thalassemia
Product: Casgevy 4 - 13 x 10^6 cells/mL dispersion for infusion

Primary endpoint: New Malignancies, New or worsening hematologic disorders (e.g. immune-mediated cytopenias, aplastic anemia, primary immunodeficiencies), All-cause mortality, All serious adverse events (SAEs) occurring up to 15 years after CTX001 infusion, CTX001-related AE's
Endpoint(s): TDT and SCD: Total Hemoglobin (Hb) concentration over time, TDT and SCD: Fetal Hemoglobin (HbF) concentration over time, TDT and SCD: Proportion of alleles with intended genetic modification present in peripheral blood over time, TDT and SCD: Proportion of alleles with intended genetic modification present in CD34+ cells of the bone marrow over time, TDT and SCD: Change in patient-reported outcome (PRO) over time in participants ≥18 years of age assessed using EuroQol quality of life scale (EQ-5D-5L) for participants from study 111,121 and 171 only

Source: https://euclinicaltrials.eu/ctis-public/view/2024-512654-19-00